EU clinical trial 2024-511879-16-00: A Phase 3, Randomized, Double-Blind, Placebo-Controlled, Efficacy and Safety Study of Povorcitinib in Participants With Prurigo Nodularis
Protocol code: INCB 54707-305
Sponsor: Incyte Corp. (Pharmaceutical company). Phase: Therapeutic confirmatory (Phase III). Countries: France (ongoing, recruitment ended), Bulgaria (ongoing, recruitment ended), Netherlands (ended), Poland (ongoing, recruitment ended), Austria (ongoing, recruitment ended), Germany (ongoing, recruitment ended), Italy (ongoing, recruitment ended).
Therapeutic area(s): Diseases [C] - Skin and Connective Tissue Diseases [C17]; Diseases [C] - Immune System Diseases [C20]
Gender: Female, Male. Age: 18-64 years, 65+ years. Enrolment: 162.
Start date (EU): 2024-12-12. Decision date: 2024-11-27. Results received: No. Last updated: 2026-04-27.
Decision dates by country: NL: 2024-12-02, FR: 2024-11-28, DE: 2024-11-27, IT: 2024-11-27, PL: 2024-12-02, BG: 2024-12-02, AT: 2024-12-02

Condition(s): Prurigo Nodularis
Product: Placebo to Povorcitinib, Povorcitinib, Povorcitinib

Primary endpoint: Proportion of participants achieving Itch NRS4 (≥ 4-point improvement [reduction] in Itch NRS score from baseline) and IGA-CPG-S-TS (IGA CPG-S score of 0 or 1 with a ≥ 2-grade improvement from baseline) at Week 24
Endpoint(s): Proportion of participants achieving Itch NRS4 at Week 24, Proportion of participants achieving IGA CPG S-TS at Week 24, Proportion of participants achieving Itch NRS4 at Week 4

Source: https://euclinicaltrials.eu/ctis-public/view/2024-511879-16-00